EU clinical trial 2024-512577-27-00: A randomised, double-blind, placebo-controlled trial with an open-label extension to assess the pharmacokinetics, safety, and efficacy of empagliflozin tablets in paediatric patients with chronic kidney disease (EMPA-KIDNEY Kids)
Protocol code: 1245-0256
Sponsor: Boehringer Ingelheim International GmbH, Boehringer Ingelheim Espana S.A. (Pharmaceutical company). Phase: Therapeutic confirmatory (Phase III). Countries: Spain (ongoing, recruiting), Germany (ongoing, recruiting), Portugal (ongoing, recruiting), Netherlands (ongoing, recruiting), Belgium (ongoing, recruiting), Poland (ongoing, recruiting), Italy (ongoing, recruiting), France (ongoing, recruiting), Sweden (ongoing, recruiting), Hungary (ongoing, recruiting).
Therapeutic area(s): Diseases [C] - Nutritional and Metabolic Diseases [C18]
Gender: Female, Male. Age: 0-17 years. Enrolment: 55.
Status: Ongoing, recruiting. Start date (EU): 2025-12-02. Decision date: 2025-11-06. Results received: No. Last updated: 2026-04-28.
Decision dates by country: DE: 2025-11-07, FR: 2025-11-06, SE: 2025-11-06, ES: 2025-11-17, HU: 2025-11-14, BE: 2025-11-07, IT: 2025-11-07, NL: 2025-11-13, PT: 2025-11-10, PL: 2025-11-15

Condition(s): Chronic kidney disease in paediatric patients
Product: Jardiance 10 mg film-coated tablets, empagliflozin, Placebo matching empagliflozin, film-coated tablets

Primary endpoint: Change from Day 1 to the Week 24 visit in UACR [mg/g], Change from Day 1 to the Week 24 visit in urine glucose [mmol/L]
Endpoint(s): Change in eGFR (U25Crea) over time during treatment with empagliflozin, Annual rate of change in eGFR (U25Crea) from Week 8 to Week 24, including treatment effect extrapolation from (adult) EMPA-KIDNEY data, Change from Day 1 to the Week 24 visit in UPCR, The observed predose plasma concentrations of empagliflozin at Week 26, Occurrence of at least one SAE or AE of special interest (AESI) per participant between Day 1 and the Week 24 visit, and between the Week 24 visit and end of treatment (EoT) +7 days residual effect period (REP)

Source: https://euclinicaltrials.eu/ctis-public/view/2024-512577-27-00